EU clinical trial 2022-502851-79-00: A Phase 3, Single-Arm, Multicenter, Open-label Extension of Study ARGX-113-2007 to Investigate the Long-term Safety, Tolerability, and Efficacy of Efgartigimod PH20 SC in Participants Aged 18 Years and Older With Active Idiopathic Inflammatory Myopathy
Protocol code: ARGX-113-2011
Sponsor: Argenx (Pharmaceutical company). Phase: Therapeutic confirmatory (Phase III). Countries: Slovakia (ended), Spain (ongoing, recruitment ended), Czechia (ongoing, recruitment ended), Italy (ongoing, recruitment ended), Belgium (ongoing, recruitment ended), Netherlands (ongoing, recruitment ended), Austria (ongoing, recruitment ended), Poland (ongoing, recruitment ended), France (ended), Hungary (ended), Ireland (ongoing, recruitment ended), Germany (ongoing, recruitment ended), Greece (ongoing, recruitment ended), Lithuania (ended), Cyprus (ended), Bulgaria (ongoing, recruitment ended), Sweden (ended), Portugal (ended), Denmark (ongoing, recruitment ended).
Therapeutic area(s): Diseases [C] - Musculoskeletal Diseases [C05]
Gender: Female, Male. Age: 18-64 years, 65+ years. Enrolment: 80.
Start date (EU): 2023-09-20. Decision date: 2023-09-05. Results received: No. Last updated: 2026-06-04.
Decision dates by country: LT: 2023-09-11, SE: 2023-09-07, CY: 2023-09-11, SK: 2023-09-05, HU: 2023-09-08, PT: 2023-09-06, FR: 2023-09-08, DK: 2023-10-02, AT: 2023-09-11, BE: 2023-09-11, BG: 2023-09-12, CZ: 2023-09-06, DE: 2023-09-07, ES: 2023-09-06, GR: 2023-09-06, IT: 2023-09-08, IE: 2023-09-08, NL: 2023-09-11, PL: 2023-09-11

Condition(s): Active Idiopathic Inflammatory Myopathy (IIM)
Product: LEFLUNOMIDE, BETAMETHASONE, MYCOPHENOLATE MOFETIL, HYDROCORTISONE, METHYLPREDNISOLONE, METHOTREXATE, ARGX-113, Efgartigimod, METHOTREXATE, HYDROXYCHLOROQUINE SULFATE, TACROLIMUS, PREDNISOLONE, AZATHIOPRINE, MYCOPHENOLIC ACID, CICLOSPORIN, DEXAMETHASONE

Primary endpoint: Incidence and severity of treatment-emergent adverse events (TEAEs), adverse event(s) of special interests (AESIs,) and serious adverse events (SAEs) by System Organ Class (SOC) and Preferred Term (PT) over time, Changes and abnormalities in vital signs, electrocardiogram (ECG), and laboratory parameters over time
Endpoint(s): Composite Glucocorticoid Toxicity Index (C-GTI) comprising the Aggregate Improvement Score (AIS) and the Cumulative Worsening Score (CWS), and Glucocorticoid Toxicity Index - Metabolic Domains (GTI-MD), over time, Prednisone dose reduction (average monthly dose) over time, Total improvement score (TIS) over time, Proportion of TIS responders (minimal, moderate, major) over time, Individual core set measure (CSMs) of the TIS over time, Percentage of participants with clinically inactive disease, defined as no evidence of disease activity, based on an Physician Global Assessment of Disease Activity (MDGA) and Extramuscular Global Assessment of the Myositis Disease Activity Assessment Tool (MDAAT) of 0 and normal creatine kinase (CK) values for at least 12 weeks (at week 28 and every 24 weeks thereafter), Percentage of participants with remission, defined as a clinically inactive disease for at least 24 weeks, during the study

Source: https://euclinicaltrials.eu/ctis-public/view/2022-502851-79-00